EU clinical trial 2024-515946-17-00: IFCT-1805 ELDERLY Phase III randomized trial of atezolizumab in elderly patients with advanced Non-Small-Cell Lung Cancer and receiving monthly carboplatin with weekly paclitaxel chemotherapy
Protocol code: IFCT-1805
Sponsor: Intergroupe Francophone De Cancerologie Thoracique (Patient organisation/association). Phase: Therapeutic confirmatory (Phase III). Countries: France (ongoing, recruitment ended).
Therapeutic area(s): Diseases [C] - Neoplasms [C04]
Gender: Female, Male. Age: 65+ years. Enrolment: 500.
Status: Ongoing, recruitment ended. Start date (EU): 2019-07-22. Decision date: 2024-12-11. Results received: No. Last updated: 2025-08-01.

Condition(s): Non Small Cell Lung Cancer
Product: Tecentriq 1 200 mg concentrate for solution for infusion, PACLITAXEL, CARBOPLATIN

Primary endpoint: Overall survival
Endpoint(s): Progression-free survival, Best overall response rate, Duration of response

Source: https://euclinicaltrials.eu/ctis-public/view/2024-515946-17-00